EU clinical trial 2025-523204-68-00: A Phase 2, randomized, multicenter, open-label neoadjuvant study evaluating zanidatamab in combination with chemotherapy in participants with HER2-positive breast cancer
Protocol code: EmpowHER 208
Sponsor: Jazz Pharmaceuticals Ireland Limited (Pharmaceutical company). Phase: Therapeutic exploratory (Phase II). Countries: Italy (temporarily halted), Spain (temporarily halted), Germany (authorised, recruitment pending).
Therapeutic area(s): Diseases [C] - Neoplasms [C04]
Gender: Female, Male. Age: 18-64 years, 65+ years. Enrolment: 100.
Start date (EU): 2026-03-25. Decision date: 2025-12-22. Results received: No. Last updated: 2026-05-08.
Decision dates by country: IT: 2025-12-22, ES: 2026-01-11, DE: 2026-05-08

Condition(s): HER2-positive breast cancer
Product: JZP598, TRASTUZUMAB EMTANSINE, DOCETAXEL, TRASTUZUMAB, PACLITAXEL, PACLITAXEL ALBUMIN-BOUND, PERTUZUMAB, CARBOPLATIN, TRASTUZUMAB EMTANSINE

Primary endpoint: Local evaluation of pCR rate in the breast and axilla (defined as ypT0/Tis ypN0 per AJCC), as determined by local site pathologist blinded to treatment assignment
Endpoint(s): Pathologic response by RCB classification and score (per NeoSTEEP criteria), Incidence, nature, and severity of TEAEs, Frequency of discontinuations of treatment due to TEAEs, Ovarian function in premenopausal women with ovaries as assessed by clinical measures and laboratory biomarkers, Rate of participants who receive surgery as intended, Rate of BCS in participants without inflammatory breast cancer, EFS, defined as time from randomization to disease progression, disease recurrence (local, regional, distant, or contralateral [invasive]), or death from any cause, Overall Survival, defined as time from randomization to death from any cause, The frequency and severity of symptomatic AEs as assessed by the PRO-CTCAE and EORTC Item Library prior to first dose of study intervention and during the on-treatment period, The percentage of all treated participants, as treated, reporting each level of side-effect bother while on treatment, based on the FACIT-GP5, Serum concentrations of zanidatamab, Frequency, duration, and time of onset of anti-zanidatamab antibodies and neutralizing antibodies, if applicable

Source: https://euclinicaltrials.eu/ctis-public/view/2025-523204-68-00